EU clinical trial 2025-520818-65-00: Evaluation of the effectiveness and tolerance of the macrogol 3350 and electrolytes combination, as a second-line intestinal preparation regimen for colonoscopy with sodium picosulfate/magnesium citrate: a randomized, placebo-controlled, study (PICO-TRAT STUDY)
Protocol code: PICO-TRAT
Sponsor: Uni-Pharma Kleon Tsetis Pharmaceutical Laboratories S.A. (Pharmaceutical company). Phase: Therapeutic confirmatory (Phase III). Countries: Greece (ongoing, recruiting).
Therapeutic area(s): Analytical,Diagnostic,Therapeutic Techniques and Equipment [E]-Surgical Procedures, Operative [E04]
Gender: Female, Male. Age: 18-64 years, 65+ years. Enrolment: 188.
Status: Ongoing, recruiting. Start date (EU): 2025-11-10. Decision date: 2025-07-18. Results received: No. Last updated: 2025-07-18.

Condition(s): Second line treatment for colonoscopy preparation
Product: The placebo has the same composition as the investigational medicinal product Clinitrat® (6.563+175,4+89,3+23,3) mg/sachet (with the exception of the active substance), is manufactured by the same manufacturer (uni-pharma kleon tsetis pharmaceutical laboratory s.a) and is not sterile., CLINITRAT® (6.563+175,4+89,3+23,3) mg/sachet ή stick, Κόνις για πόσιμο διάλυμα

Primary endpoint: Adequate bowel preparation, as defined by a total BBPS score ≥6 and a score per segment ≥2.
Endpoint(s): Average BBPS total score, Partial BBPS sub-score for the right (ascending) colon, Polyp detection rate, Percentage of colonoscopies reaching the cecum, Patient tolerance, which will be assessed based on a questionnaire assessing the tolerance of the preparation translated and updated in Greek

Source: https://euclinicaltrials.eu/ctis-public/view/2025-520818-65-00